EU clinical trial 2024-514799-42-00: Glucocorticoids versus placebo for the treatment of acute exacerbation of idiopathic pulmonary fibrosis: a randomized controlled trial
Protocol code: EXAFIP2
Sponsor: GIE Groupe hospitalier Paris Saint-Joseph/Vinci (Hospital/Clinic/Other health care facility). Phase: Therapeutic exploratory (Phase II). Countries: France (authorised, recruiting).
Therapeutic area(s): Diseases [C] - Respiratory Tract Diseases [C08]
Gender: Female, Male. Age: 18-64 years, 65+ years. Enrolment: 110.
Status: Authorised, recruiting. Start date (EU): 2024-11-05. Decision date: 2024-11-05. Results received: No. Last updated: 2025-08-04.

Condition(s): IDIOPATHIC PULMONARY FIBROSIS
Product: Sucrose octaacetate [NF], SODIUM CHLORIDE, METHYLPREDNISOLONE VIATRIS 1 g, poudre pour solution injectable (I.V.), LIQUID PREDNISONE

Primary endpoint: Parameter: all-cause mortality rate; Timetable: Day 30.
Endpoint(s): vital status assessment at Day 30 and Day 90 with time (in days) between randomization and death, Overall mortality at Day 90, Death or transplantation at Day 90, Mortality linked to the respiratory disease at Day 30 and Day 90, Time (in days) from randomization to worsening, percentage of patients admitted to ICU, Percentage of patients requiring invasive ventilation, length of hospital-stay, Progression of pulmonary fibrosis, Absolute change in percent Forced Vital Capacity and DLCO, Infectious disease, Capillary blood glucose monitoring and/or fasting blood glucose daily from D1 to hospital withdraw, discharge hospital visit, Day 30, Day 90, Cardiovascular disorder ( heart rate, blood pressure, clinical history daily), Neuropsychological disturbances, Clinical laboratory evaluation (blood count, serum chemistries and creatinin measurement), Dyspnea evaluation, Hospital Anxiety and Depression Scale (HADs), 7-category ordinal scale at day 15

Source: https://euclinicaltrials.eu/ctis-public/view/2024-514799-42-00